EU clinical trial 2024-518036-36-03: FUnctional selection of advanced breast cancer patients for Talazoparib treatment Using the REpair Capacity (RECAP) test: The FUTURE trial
Sponsor: Erasmus Universitair Medisch Centrum Rotterdam (Erasmus MC) (Hospital/Clinic/Other health care facility). Phase: Therapeutic use (Phase IV). Countries: Netherlands (ended).
Therapeutic area(s): Diseases [C] - Neoplasms [C04]
Gender: Female, Male. Age: 18-64 years, 65+ years. Enrolment: 78.
Status: Ended. Start date (EU): 2019-09-20. End date (EU): 2025-04-22. Decision date: 2025-01-31. Results received: No. Last updated: 2025-01-31.

Condition(s): Breast cancer
Product: Talzenna 1 mg hard capsules

Primary endpoint: The aim of the current study is to assess the predictive potential of the RECAP test for in vivo response to talazoparib treatment by investigating the percentage of patients with HRD breast tumors with PFS on talazoparib monotherapy of 4 months or longer. The main endpoint is thus the proportion of patients with PFS at 4 months (PFS4).
Endpoint(s): Secondary endpoints are overall response rate (ORR), overall survival (OS) among patients with HRD tumors treated with talazoparib. The negative predictive value will be determined within the HRP group.

Source: https://euclinicaltrials.eu/ctis-public/view/2024-518036-36-03